EU clinical trial 2023-507196-22-00: A PHASE III, RANDOMIZED, DOUBLE-BLIND, PLACEBO-CONTROLLED, MULTICENTER STUDY TO EVALUATE THE EFFICACY, SAFETY, PHARMACOKINETICS, AND PHARMACODYNAMICS OF SATRALIZUMAB AS MONOTHERAPY OR IN ADDITION TO BASELINE THERAPY IN PATIENTS WITH MYELIN OLIGODENDROCYTE GLYCOPROTEIN ANTIBODY-ASSOCIATED DISEASE (MOGAD)
Protocol code: WN43194
Sponsor: F. Hoffmann-La Roche AG (Pharmaceutical company). Phase: Therapeutic confirmatory (Phase III). Countries: Germany (ongoing, recruitment ended), Italy (ongoing, recruitment ended), France (ongoing, recruitment ended), Poland (ongoing, recruitment ended).
Therapeutic area(s): Diseases [C] - Nervous System Diseases [C10]
Gender: Female, Male. Age: 0-17 years, 18-64 years, 65+ years. Enrolment: 73.
Status: Ongoing, recruitment ended. Start date (EU): 2022-06-20. Decision date: 2024-01-31. Results received: No. Last updated: 2026-06-08.
Decision dates by country: PL: 2025-05-04, IT: 2024-01-31, FR: 2024-03-08, DE: 2024-01-31

Condition(s): Myelin Oligodendrocyte Glycoprotein Antibody-Associated Disease (MOGAD)

Primary endpoint: 1. Time from randomization to the first occurrence of a MOGAD relapse in the DB treatment period, as determined by an adjudication committee (CEC)
Endpoint(s): 1. Rate of adjudicated MOGAD relapses, 2. Active lesions on MRI of the neuroaxis (Gd-enhancing or new/enlarging T2 hyperintense lesions measured across the optic nerve, the spinal cord and the brain, including brainstem and cerebellum), 3. Proportion of participants receiving rescue therapy, 4. Rate of inpatient hospitalizations (defined as more than an overnight stay, excluding those for elective procedures), 5. Proportion of relapse-free participants at 6-month intervals, 6. Change from baseline in total Montreal cognitive assessment (MoCA) score (adolescents only), 7. Incidence, seriousness and severity of adverse events, with severity determined according to National Cancer Institute Common Terminology Criteria for Adverse Events version 5.0 (NCI CTCAE v5.0), 8. Change from baseline in targeted vital signs, 9. Change from baseline in targeted electrocardiogram (ECG) parameters, 10. Change from baseline in targeted clinical laboratory test results, 11. Change from baseline in suicidality, as determined by Columbia-Suicide Severity Rating Scale, 12. Change from baseline in weight

Source: https://euclinicaltrials.eu/ctis-public/view/2023-507196-22-00